EU clinical trial 2024-511810-18-00: A controlled, open-label post-authorisation efficacy and safety study in imlifidase desensitised kidney transplant patients with positive crossmatch against a deceased donor prior to imlifidase treatment, including non-comparative registry and concurrent reference cohorts
Protocol code: 20-HMedIdeS-19
Sponsor: Hansa Biopharma AB (Pharmaceutical company). Phase: Therapeutic confirmatory (Phase III). Countries: Germany (ended), Sweden (ended), Belgium (ended), Czechia (ended), Austria (ended), Italy (ended), Netherlands (ended), Spain (ended), Slovenia (ended), France (ended).
Therapeutic area(s): Phenomena and Processes [G] - Immune system processes [G12]
Gender: Female, Male. Age: 18-64 years, 65+ years. Enrolment: 144.
Status: Ended. Start date (EU): 2022-04-19. End date (EU): 2026-04-21. End date: 2026-04-22. Decision date: 2024-09-17. Results received: No. Last updated: 2025-12-17.
Decision dates by country: SI: 2024-09-30, AT: 2024-09-20, BE: 2024-09-17, DE: 2024-09-20, CZ: 2024-09-17, SE: 2024-09-17, IT: 2024-09-24, FR: 2024-10-01, ES: 2024-09-26, NL: 2024-09-17

Condition(s): End stage chronic kidney disease (CKD) patients who are highly sensitised and on the kidney transplant list awaiting a kidney transplant
Product: Idefirix 11 mg powder for concentrate for solution for infusion

Primary endpoint: 1-year graft failure-free survival in patients who have been kidney transplanted after imlifidase treatment
Endpoint(s): Renal function at several time points between 24 hours and 2 weeks and at 1, 3 and 6 months and 1 year after transplantation as assessed by estimated glomerular filtration rate (eGFR) and serum/plasma creatinine levels (imlifidase cohort), Patient survival at 1 year after transplantation (imlifidase cohort), Graft survival at 1 year after transplantation (imlifidase cohort), Proportion of patients with conversion of a positive crossmatch test to negative within 24 hours after imlifidase treatment, HLA/DSA antibody levels at several time points between pre-dose imlifidase and 2 weeks, and at 1, 3 and 6 months and 1 year after imlifidase treatment, Imlifidase PK up to 14 days after imlifidase treatment, Imlifidase PD up to 9 days after imlifidase treatment, ADAs up to 1 year after imlifidase treatment, Frequency of DGF (imlifidase cohort), Proportion of patients with biopsy- and serology (DSA)-confirmed AMRs over 1 year (imlifidase cohort), Proportion of patients with biopsy confirmed CMRs over 1 year (imlifidase cohort), Safety over 1 year as measured by reported SAEs (imlifidase cohort), Safety assessed as proportion of patients with infusion-related reactions within 48 hours of imlifidase infusion, Safety assessed as proportion of patients with severe or serious infections within 30 days after transplantation (imlifidase cohort), Change in patient-reported life participation, as measured by the PROMIS Social Health domain “Ability to participate in social roles & activities, PROMIS-SF-8a”, from baseline to 1 year after transplantation (imlifidase cohort), Graft failure-free survival at 1 year after transplantation (concurrent reference cohort), Renal function at 1, 3 and 6 months and 1 year after transplantation as assessed by eGFR and serum/plasma creatinine levels (concurrent reference cohort), Patient survival at 1 year after transplantation (concurrent reference cohort), Graft survival at 1 year after transplantation (concurrent reference cohort), Frequency of DGF (concurrent reference cohort), Proportion of patients with biopsy- and serology (DSA)-confirmed AMRs over 1 year (concurrent reference cohort), Proportion of patients with biopsy confirmed CMRs over 1 year (concurrent reference cohort), Safety over 1 year as measured by reported SAEs (concurrent reference cohort), Safety assessed as proportion of patients with severe or serious infections within 30 days after transplantation (concurrent reference cohort), Change in patient reported life participation, as measured by the PROMIS Social Health domain “Ability to participate in social roles & activities, PROMIS-SF-8a”, from baseline to 1 year after transplantation (concurrent reference cohort), Graft survival at 1 year after transplantation (historical reference cohort), Renal function at 3 and 6 months, and 1 year as measured by serum/plasma creatinine category (<130 µmol/L, 130-259 µmol/L, 260-400 µmol/L and >400 µmol/L) (eGFR only available in selected patients) (historical reference cohort), Patient survival at 1 year after transplantation (historical reference cohort), Proportion of patients with rejection episodes (AMRs and CMRs) during the first post-transplant year in patients with a functioning graft at the end of the first posttransplant year (historical reference cohort)

Source: https://euclinicaltrials.eu/ctis-public/view/2024-511810-18-00